EU clinical trial 2024-511104-16-00: Molecular theranostics for metastatic prostate cancer: PSMA, FAPI, or both?
Sponsor: Turku University Hospital (Hospital/Clinic/Other health care facility). Phase: Therapeutic exploratory (Phase II). Countries: Finland (authorised, recruitment pending).
Therapeutic area(s): Diseases [C] - Male Urogenital Diseases [C12]
Gender: Male. Age: 18-64 years, 65+ years. Enrolment: 40.
Status: Authorised, recruitment pending. Decision date: 2024-02-28. Results received: No. Last updated: 2024-02-28.

Condition(s): Prostate cancer
Product: [18F]FAPI-74, 18F-DCFPyL CURIUM, 1000 MBq/mL solution for injection

Primary endpoint: The proportion of subject with PSMA- and/or FAPI-positive metastases and number of metastases
Endpoint(s): The proportion of detected metastasis with 18F-FAPI-74 PET/CT compared to the 18F-DCFPyL PET/CT, The sensitivity, specificity, accuracy, and area under the receiver-operating characteristic curve (AUC) values of 18F-DCFPyL PET/CT and 18F-FAPI-74 PET/CT in detecting metastatic subjects

Source: https://euclinicaltrials.eu/ctis-public/view/2024-511104-16-00